EU clinical trial 2024-517094-24-00: A randomized phase II clinical trial on intratumoral AS01B/ipilimumab plus intravenous nivolumab with or without autologous CD1c(BDCA-1)+ / CD141(BDCA-3)+ myeloid dendritic cells.
Sponsor: UZ Brussel (Hospital/Clinic/Other health care facility). Phase: Phase I and Phase II (Integrated)- Other. Countries: Belgium (ongoing, recruiting).
Therapeutic area(s): Not possible to specify
Gender: Female, Male. Age: 18-64 years, 65+ years. Enrolment: 18.
Status: Ongoing, recruiting. Start date (EU): 2018-01-08. Decision date: 2024-09-16. Results received: No. Last updated: 2026-03-19.

Condition(s): Solid tumors
Product: OPDIVO 10 mg/mL concentrate for solution for infusion., YERVOY 5 mg/ml concentrate for solution for infusion

Primary endpoint: 1-year progression free survival (PFS) rate following randomization. Adverse events occurring in patients treated in this phase II clinical trial will be collected on a continuous basis and monitored. Frequency and severity (graded according to the CTCAEv5) will be reported descriptively, Type, frequency and severity (graded according to the CTCAEv5.0) of intratumoral injection of CD1c (BDCA-1)+ / CD141 (BDCA-3)+ myDC's with IT AS01B and IT ipilimumab in combination with IV nivolumab
Endpoint(s): Percentage of study patients that can receive the planned CD1c (BDCA-1)+ / CD141 (BDCA-3)+ myDC intratumoral injection., Number/volume of administered CD1c (BDCA-1)+ / CD141 (BDCA-3)+ myDC administered dose of AS01, ipilimumab, and nivolumab, Tumor response (ORR) according to RECISTv1.1 and iRECIST • Tumor response and duration of response of CD1c (BDCA-1)+ / CD141 (BDCA-3)+ myDC,AS01 and ipilimumab injected and non-injected metastases (reported descriptively), Duration of response of CD1c • (BDCA-1)+ / CD141 (BDCA-3)+ • myDC, AS01B and • ipilimumab in injected and noninjected metastases (reported • descriptively), Time from first study treatment administration to progression of disease according to RECISTv1.1 and iRECIST (and possibly itRECIST), Time from first study treatment administration to death

Source: https://euclinicaltrials.eu/ctis-public/view/2024-517094-24-00